EU clinical trial 2024-518568-11-00: Allogeneic hematopoietic cell transplantation from HLA-matched donor after Flu-Mel-PTCy versus Flu-Mel-ATG reduced-intensity conditioning: a phase II randomized study from the Belgian Hematology Society (BHS)
Protocol code: TJB1703
Sponsor: Centre Hospitalier Universitaire De Liege (Hospital/Clinic/Other health care facility). Phase: Therapeutic exploratory (Phase II). Countries: Belgium (ongoing, recruiting).
Therapeutic area(s): Diseases [C] - Immune System Diseases [C20]; Diseases [C] - Neoplasms [C04]
Gender: Female, Male. Age: 18-64 years, 65+ years. Enrolment: 114.
Status: Ongoing, recruiting. Start date (EU): 2019-02-04. Decision date: 2024-10-23. Results received: No. Last updated: 2025-07-01.

Condition(s): Hematological malignancies confirmed histologically: - AML in morphological CR or not in morphological CR but not rapidly progressing (i.e. no need to give treatments such as hydroxyurea to maintain WBC count < 10 000 x109/mL); - MDS; - CML in CP or AP; - MPD not in blast crisis, - MDS/MPD overlap, - ALL in CR; - Multiple myeloma; - CLL; - Non-Hodgkin’s lymphoma (aggressive NHL should have chemosensitive disease); - Hodgkin’s disease with chemosensitive disease or responding to checkpoint inhibitors.
Product: Endoxan 500 mg - poudre pour solution injectable, THYMOGLOBULINE 5 mg/ml poudre pour solution pour perfusion

Primary endpoint: To assess the current GVHD-free, relapse-free survival (cGRFS) for patients conditioned with FM-PTCy or FM-ATG
Endpoint(s): 1. To assess cGRFS for patients conditioned with FM-PTCy or FM-ATG separately in those transplanted with a related or an unrelated donor., 2. To assess the relapse/progression rate for patients conditioned with FM-PTCy or FM-ATG., 3. To assess the rates of grade II-IV and III-IV acute (at 6 months) and moderate/severe cGVHD (at 24 months) in patients conditioned with FM-PTCy or FM-ATG., 4. To assess the rates of NRM as well as LFS and OS in patients conditioned with FM-PTCy or FM-ATG., 5. To assess the proportion of patients alive without active disease and without systemic immunosuppression 1, 2, 3, 4, 5, 7, 10 and 15-years after transplantation in patients conditioned with FM-PTCy or FM-ATG.

Source: https://euclinicaltrials.eu/ctis-public/view/2024-518568-11-00